EU clinical trial 2022-500633-92-00: Ikervis in the Treatment of Atopic Keratoconjunctivitis - a Prospective, Randomized, Placebo-Controlled Trial
Sponsor: Rigshospitalet (Hospital/Clinic/Other health care facility). Phase: Therapeutic exploratory (Phase II). Countries: Denmark (ongoing, recruiting).
Therapeutic area(s): Diseases [C] - Eye Diseases [C11]
Gender: Female, Male. Age: 18-64 years, 65+ years. Enrolment: 40.
Status: Ongoing, recruiting. Start date (EU): 2025-05-09. Decision date: 2023-12-13. Results received: No. Last updated: 2026-06-01.

Condition(s): Atopic Keratoconjunctivitis
Product: IKERVIS 1 mg/mL eye drops, emulsion, Cationorm PRO is a autorized medical device that contains no pharmeceutical ingredient.

Primary endpoint: Change from baseline to 4 months follow-up in the Bulbar Redness (BR) score measured on the Keratograph 5M (K5M, Oculus®) with an R-scan, Automatic Classification of Redness.
Endpoint(s): Ocular discomfort as described by patients on 100 mm VAS, Ocular Surface Disease Index (OSDI) score, Ocular surface staining (Oxford score), Tear osmolarity (TearLab®), Tear meniscus height (TMH, K5M), Non-invasive tear break-up time (NIKBUT, K5M), Meibography (JENVIS Meibo Grading Scale, K5M), Schirmer’s I test, Fluorescein tear break-up time (TBUT)

Source: https://euclinicaltrials.eu/ctis-public/view/2022-500633-92-00